EU clinical trial 2023-510455-28-00: A Multicentre, Randomised, Double-blind, Parallel-group, Placebo-controlled, 24-Week Phase III Study with an Open-label Extension to Evaluate the Efficacy and Safety of Benralizumab in Patients with Hypereosinophilic Syndrome (HES)
Protocol code: D3254C00001
Sponsor: AstraZeneca AB (Pharmaceutical company). Phase: Therapeutic confirmatory (Phase III). Countries: Belgium (ongoing, recruitment ended), Spain (ended), Austria (ongoing, recruitment ended), Netherlands (ongoing, recruitment ended), Italy (ended), Poland (ongoing, recruitment ended), France (ongoing, recruitment ended), Germany (ongoing, recruitment ended), Denmark (ongoing, recruitment ended).
Therapeutic area(s): Diseases [C] - Hemic and Lymphatic Diseases [C15]
Gender: Female, Male. Age: 0-17 years, 18-64 years, 65+ years. Enrolment: 60.
Start date (EU): 2020-06-10. Decision date: 2024-07-05. Results received: No. Last updated: 2026-08-03.
Decision dates by country: IT: 2024-07-29, ES: 2024-07-18, PL: 2024-08-06, FR: 2024-07-10, DK: 2024-07-10, NL: 2024-07-05, DE: 2024-07-12, BE: 2024-07-11, AT: 2024-07-15

Condition(s): Hypereosinophilic Syndrome (HES)
Product: Fasenra 30 mg solution for injection in pre-filled syringe, Placebo, Benralizumab Placebo for clinical trials is a sterile liquid solution presented in an accessorized prefilled syringe (APFS) for subcutaneous injection. Please refer to the IMPD documentation enclosed.

Primary endpoint: "Time to first HES worsening/flare - Population b: Full analysis set - Intercurrent event strategy b: Included in analysis regardless of treatment discontinuation (treatment policy) - Population-level summary: Hazard ratio (HES worsening/flare: HES clinical manifestations or lab abnormalities that result in an increase/burst of oral corticosteroids (OCS) ≥10 mg/day for at least 2 days OR an increase, or addition of new cytotoxic and/or immunosuppressive therapy, OR hospitalization)"
Endpoint(s): "DB treatment period: - Key: Proportion of patients who experience an HES worsening/flare during the DB period - Key: Number of HES worsenings/flares (annualised rate/year) during the DB period - Key: Time to first haematologic relapse (AEC ≥ 1000 cells/μL) during the DB period - Key: Fatigue severity (PROMIS fatigue short form 7a) at Week 24 - Proportion of patients who: - have haematologic relapse during the DB period - have AEC < 500 cells/μL for 24 weeks - require an increase in [...], "OLE treatment period: - Proportion of patients who experience an HES worsening/flare - Annualized rate of HES worsening/flare - Fatigue (PROMIS fatigue short form 7a) - Safety and tolerability will be evaluated in terms of AEs, vital signs and clinical laboratory assessments - Serum benralizumab concentrations, anti-benralizumab antibodies and nAbs - HES symptom questionnaire - HRQoL (SF-36v2)"

Source: https://euclinicaltrials.eu/ctis-public/view/2023-510455-28-00